EU clinical trial 2024-513271-41-00: A phase 1/2 study exploring the safety and activity of Trifluridine/Tipiracil in combination with Capecitabine and Bevacizumab in metastatic colorectal cancer patients. The TriComB trial
Protocol code: TRICOMB
Sponsor: Fondazione GONO G.I. (Patient organisation/association). Phase: Therapeutic exploratory (Phase II). Countries: Italy (ongoing, recruitment ended).
Therapeutic area(s): Diseases [C] - Neoplasms [C04]
Gender: Female, Male. Age: 18-64 years, 65+ years. Enrolment: 36.
Status: Ongoing, recruitment ended. Start date (EU): 2024-09-16. Decision date: 2024-09-16. Results received: No. Last updated: 2026-06-03.

Condition(s): colorectal metastatic cancer, metastatic colorectal cancer
Product: BEVACIZUMAB, CAPECITABINE, Lonsurf 20 mg/8.19 mg film-coated tablets, Lonsurf 15 mg/6.14 mg film-coated tablets

Primary endpoint: Objective Response Rate (ORR) is defined as the percentage of patients, relative to the total of enrolled subjects, achieving a complete (CR) or partial (PR) response, according to RECIST 1.1 criteria, determined by investigator reported measurements. According to RECIST 1.1 criteria and the non-randomised nature of the study, a confirmation of CR and PR is required.
Endpoint(s): Overall Toxicity Rate is defined as the percentage of patients, relative to the total of enrolled subjects, experiencing any adverse event, according to National Cancer Institute Common Toxicity Criteria (version 5.0), Toxicity Rate is defined as the percentage of patients, relative to the total of enrolled subjects, experiencing a specific adverse event of grade 3/4, according to National Cancer Institute Common Toxicity Criteria (version 5.0)., Progression Free Survival (PFS), Overall Survival (OS), The analysis of PROs endpoints

Source: https://euclinicaltrials.eu/ctis-public/view/2024-513271-41-00